EU clinical trial 2025-523533-25-00: Adaptive, Phase 2/3, Randomized, Double-Blind Trial Investigating the Efficacy and Safety of Visugromab versus Placebo in Patients with Cancer-associated Cachexia
Protocol code: CTL-002-006
Sponsor: CatalYm GmbH (Pharmaceutical company). Phase: Phase II and Phase III (Integrated). Countries: France (ongoing, recruiting), Czechia (authorised, recruiting), Romania (ongoing, recruiting), Italy (ongoing, recruiting), Germany (authorised, recruiting), Poland (ongoing, recruiting), Spain (ongoing, recruiting), Bulgaria (ongoing, recruiting), Norway (authorised, recruiting), Ireland (authorised, recruitment pending), Netherlands (authorised, recruitment pending).
Therapeutic area(s): Diseases [C] - Nutritional and Metabolic Diseases [C18]
Gender: Female, Male. Age: 18-64 years, 65+ years. Enrolment: 434.
Start date (EU): 2026-03-26. Decision date: 2026-02-13. Results received: No. Last updated: 2026-07-01.
Decision dates by country: BG: 2026-02-18, CZ: 2026-02-17, FR: 2026-02-13, DE: 2026-02-18, IT: 2026-02-17, NO: 2026-02-18, PL: 2026-02-22, RO: 2026-02-17, IE: 2026-05-29, NL: 2026-06-01, ES: 2026-02-18

Condition(s): Cancer-associated Cachexia
Product: Placebo matching Visugromab (CTL-002), Visugromab (CTL-002)

Primary endpoint: Change from baseline in body weight at 12 weeks; change from baseline in appetite at 12 weeks, measured on the 5-item anorexia subscale of the FAACT instrument, 12 weeks
Endpoint(s): 1. Skeletal muscle mass/index by L3 CT/MRI scan; Functional endpoint (30-second chair stand test); Non-sedentary physical activity; Overall survival (OS); Tumor response; Responder analysis, 2. Incidence, type, and severity of treatment emergent Adverse Events (TEAEs), treatment-related AEs and serious AEs (SAEs), discontinuation due to TEAEs, 3. Patient-reported outcomes: Functional Assessment of Anorexia/Cachexia Therapy (FAACT); Patient Global Impression of Severity (PGI-S); Patient Global Impression of Change (PGI-C); EORTC-QLQ-C15 PAL, 4. Maximum plasma concentration (Cmax); Minimum plasma concentration (Cmin)

Source: https://euclinicaltrials.eu/ctis-public/view/2025-523533-25-00